EU clinical trial 2024-518265-10-01: A Phase I, First In Human, open-label study of escalating doses of INA03 administered intravenously as single agent in adult patients with relapse/refractory Acute Leukemia
Sponsor: Institut Paoli Calmettes (Hospital/Clinic/Other health care facility). Phase: Human Pharmacology (Phase I)- First administration to humans. Countries: France (ended).
Therapeutic area(s): Diseases [C] - Neoplasms [C04]; Diseases [C] - Immune System Diseases [C20]
Gender: Female, Male. Age: 18-64 years, 65+ years. Enrolment: 24.
Status: Ended. Start date (EU): 2020-06-03. End date (EU): 2025-02-24. Decision date: 2024-12-04. Results received: No. Last updated: 2024-12-04.

Condition(s): Relapse/ refractory acute Leukemia

Source: https://euclinicaltrials.eu/ctis-public/view/2024-518265-10-01